EU clinical trial 2024-511057-22-00: A Randomized, Double-blind, Multicenter, Placebo-controlled Study of Adjunctive Aticaprant Plus an Antidepressant for Relapse Prevention in Major Depressive Disorder (MDD) With Moderate-to-severe Anhedonia
Protocol code: 67953964MDD3005
Sponsor: Janssen Cilag International (Pharmaceutical company). Phase: Therapeutic confirmatory (Phase III). Countries: Bulgaria (ended), Greece (ended), Spain (ended), Czechia (ended), France (ended), Romania (ended), Poland (ended), Germany (ended), Belgium (ended).
Therapeutic area(s): Psychiatry and Psychology [F] - Mental Disorders [F03]
Gender: Female, Male. Age: 18-64 years. Enrolment: 339.
Status: Ended. Start date (EU): 2024-12-04. End date (EU): 2025-02-28. End date: 2025-04-25. Decision date: 2024-11-18. Results received: Yes. Last updated: 2024-12-12.
Decision dates by country: BE: 2024-11-18, BG: 2024-11-25, CZ: 2024-11-21, FR: 2024-11-21, DE: 2024-11-20, GR: 2024-11-18, RO: 2024-11-21, PL: 2024-11-24, ES: 2024-11-18

Condition(s): Major Depressive Disorder (MDD) with Moderate-to-severe Anhedonia
Product: Matching placebo tablet, JNJ-67953964

Primary endpoint: Time from randomization into the DB treatment maintenance phase to the first documentation of a relapse event

Source: https://euclinicaltrials.eu/ctis-public/view/2024-511057-22-00